EU clinical trial 2022-501146-30-00: A Long-Term Follow-up Study to Evaluate the Safety and Efficacy of Adeno-Associated Virus (AAV) Serotype 8 (AAV8)-Mediated Gene Transfer of Human Ornithine Transcarbamylase (OTC) in Adults with Late-Onset OTC Deficiency
Sponsor: Ultragenyx Pharmaceutical Inc. (Pharmaceutical company). Phase: Phase I and Phase II (Integrated)- Other. Countries: France (ongoing, recruitment ended), Spain (ongoing, recruitment ended).
Therapeutic area(s): Diseases [C] - Congenital, Hereditary, and Neonatal Diseases and Abnormalities [C16]
Gender: Female, Male. Age: 18-64 years, 65+ years. Enrolment: 4.
Status: Ongoing, recruitment ended. Start date (EU): 2018-09-17. Decision date: 2022-11-03. Results received: No. Last updated: 2025-11-18.
Decision dates by country: ES: 2022-11-03, FR: 2022-12-16

Condition(s): Ornithine transcarbamylase deficiency
Product: Avalotcagene ontaparvovec

Primary endpoint: The incidence of AEs and SAEs for each dosing cohort assessed by severity and relationship to study product.
Endpoint(s): The change from baseline (Day 0 of Study 301OTC01) in AUC0-24 for plasma ammonia over time to 208 weeks following IV administration of DTX301, The change from baseline (the baseline of each subject before DTX301 administration in Study 301OTC01) in the rate of ureagenesis (as measured by the generation of [13 C]urea over 4 hours) as determined by gas chromatography mass spectrometry over time to 416 weeks following IV administration of DTX301 The rate of ureagenesis was assessed prior to Amendment 3; ureagenesis data collected will be analyzed as a secondary efficacy endpoint.

Source: https://euclinicaltrials.eu/ctis-public/view/2022-501146-30-00